EU clinical trial 2023-506153-38-00: A Randomized, Double-blind, Placebo-controlled, Phase 3 Study of Apalutamide in Subjects with High-risk, Localized or Locally Advanced Prostate Cancer Who are Candidates for Radical Prostatectomy
Protocol code: 56021927PCR3011
Sponsor: Janssen - Cilag International (Pharmaceutical company). Phase: Therapeutic confirmatory (Phase III). Countries: Spain (ongoing, recruitment ended), Netherlands (ongoing, recruitment ended), France (ongoing, recruitment ended), Germany (ongoing, recruitment ended), Italy (ongoing, recruitment ended), Czechia (ongoing, recruitment ended), Poland (ongoing, recruitment ended).
Therapeutic area(s): Diseases [C] - Neoplasms [C04]
Gender: Male. Age: 18-64 years, 65+ years. Enrolment: 668.
Status: Ongoing, recruitment ended. Start date (EU): 2019-07-11. Decision date: 2023-10-03. Results received: No. Last updated: 2026-02-20.
Decision dates by country: ES: 2023-10-03, DE: 2023-10-09, PL: 2023-11-10, NL: 2023-10-05, IT: 2023-10-10, CZ: 2023-10-19, FR: 2023-10-05

Condition(s): High-risk localized or locally advanced prostate cancer
Product: JNJ-56021927, Apalutamide - Film-coated tablet

Primary endpoint: pCR rate (as defined in the pathology charter and assessed by a pathology blinded independent central review [BICR]), MFS based on conventional or PSMA PET imaging (defined as the time from randomization to the date of the first occurrence of radiographic distant metastasis on conventional [ie, CT/MRI and bone scan] or PSMA PET imaging evaluated by radiology BICR, pathologic finding of distant metastasis, or death from any cause, whichever occurs first).

Source: https://euclinicaltrials.eu/ctis-public/view/2023-506153-38-00